EU clinical trial 2025-523448-10-00: Efficacy of cell therapy with allo-MSCs in patients with gvhd resistant to ruxolitinib second line therapy: a Phase IIB Clinical Trial - MSC-GRR2 Study
Sponsor: Azienda Socio Sanitaria Territoriale Degli Spedali Civili Di Brescia (Hospital/Clinic/Other health care facility). Phase: Therapeutic exploratory (Phase II). Countries: Italy (authorised, recruitment pending).
Therapeutic area(s): Diseases [C] - Hemic and Lymphatic Diseases [C15]
Gender: Female, Male. Age: 18-64 years, 65+ years. Enrolment: 26.
Status: Authorised, recruitment pending. Decision date: 2026-04-28. Results received: No. Last updated: 2026-04-28.

Condition(s): Gvhd Resistant to ruxolitinib and steroids
Product: MC0518

Primary endpoint: Overall response rate (ORR) on day 28, defined as the sum of complete and partial responses according to modified MAGIC/Glucksberg criteria.
Endpoint(s): ORR at day 56 and at 3 months, Best overall response within 3 months, Duration of response, Cumulative corticosteroid dose up to day 56 and at 3 months, Overall survival (OS) and progression-free survival (PFS) at 6 and 12 months, Non-relapse mortality (NRM) at 3, 6, and 12 months, Incidence of chronic GvHD at 12 months, Rate of corticosteroid discontinuation, Impact on quality of life (EQ-5D) at end of treatment and during follow-up, Safety profile up to 12 months, including incidence of serious adverse events, late infections, and product-related toxicities

Source: https://euclinicaltrials.eu/ctis-public/view/2025-523448-10-00